EU clinical trial 2023-505694-32-00: Optimizing treatment strategy in axial spondyloarthritis by molecular imaging with Technetium-labeled certolizumab pegol.
Protocol code: SCINTRA-3
Sponsor: Universitair Ziekenhuis Gent (Hospital/Clinic/Other health care facility). Phase: Therapeutic confirmatory (Phase III). Countries: Belgium (ongoing, recruiting).
Therapeutic area(s): Diseases [C] - Immune System Diseases [C20]; Analytical, Diagnostic and Therapeutic Techniques and Equipment [E] - Investigative Techniques [E05]; Diseases [C] - Musculoskeletal Diseases [C05]
Gender: Female, Male. Age: 18-64 years, 65+ years. Enrolment: 78.
Status: Ongoing, recruiting. Start date (EU): 2024-08-29. Decision date: 2024-01-19. Results received: No. Last updated: 2024-10-24.
Decision dates by country: BE: 2024-05-15

Condition(s): Axial Spondyloarthritis
Product: 99mTc Certolizumab Pegol (UZ Gent)

Primary endpoint: Difference in response rates (defined as ASDAS (Ankylosing Spondylitis Disease Activity Score) clinically important improvement) to immunomodulating (bDMARDs and tsDMARDs) agents between screening and 12 (±2) weeks after treatment initiation between patients with positive and negative immunoscintigraphy. Response is based on changes in disease activity scores.
Endpoint(s): Difference in response rates (defined as ASDAS clinically important improvement and Assessment of Spondyloarthritis international Society 40 response (ASAS 40 response)) to immunomodulating agents between screening and after week 24 (±2) weeks after treatment initiation between patients with positive and negative immunoscintigraphy., Difference in diagnostic certainty of active disease assessment based on the existing decision algorithm versus an algorithm including immunoscintigraphy., Correlation between magnetic resonance imaging and immunoscintigraphy results at baseline when the immunoscintigraphy will be performed., Evolution of patient reported outcomes (PROs), collected in the form of standardized questionnaires, used in routine clinical practice, and laboratory markers of inflammation (serum levels of CRP and ESR), tested in routine clinical practice, from baseline up to 12 (±2) and 24 (±2) weeks after treatment initiation., Exploratory trial endpoints: The costs of quality-adjusted life-year and impact on treatment budget will be assessed in all included patients by standardized questionnaires.

Source: https://euclinicaltrials.eu/ctis-public/view/2023-505694-32-00